EU clinical trial 2023-508463-71-00: A Phase 3, Randomized, Open-Label, Multicenter Study Comparing Ponatinib Versus Imatinib, Administered in Combination with Reduced-Intensity Chemotherapy, in Patients with Newly Diagnosed Philadelphia Chromosome-Positive Acute Lymphoblastic Leukemia (Ph+ ALL)
Protocol code: Ponatinib-3001
Sponsor: Takeda Development Center Americas Inc. (Pharmaceutical company). Phase: Therapeutic confirmatory (Phase III). Countries: Spain (ongoing, recruitment ended), Italy (ongoing, recruitment ended), Austria (ongoing, recruitment ended), Poland (ongoing, recruitment ended), Greece (ongoing, recruitment ended), France (ongoing, recruitment ended).
Therapeutic area(s): Diseases [C] - Hemic and Lymphatic Diseases [C15]
Gender: Female, Male. Age: 18-64 years, 65+ years. Enrolment: 91.
Status: Ongoing, recruitment ended. Start date (EU): 2018-11-30. Decision date: 2024-05-06. Results received: No. Last updated: 2025-10-31.
Decision dates by country: AT: 2024-05-10, PL: 2024-05-16, IT: 2024-05-13, FR: 2024-05-21, ES: 2024-05-06, GR: 2024-06-17

Condition(s): Newly Diagnosed Philadelphia Chromosome-Positive Acute Lymphoblastic Leukemia (Ph+ ALL)
Product: PONATINIB, PONATINIB, Ponatinib, IMATINIB, IMATINIB

Primary endpoint: Primary efficacy endpoint: MRD-negative CR (BCR-ABL/ABL1 ≤0.01% and meeting criteria for CR)
Endpoint(s): EFS is defined as the dates of randomization until death due to any cause or failure to achieve CR by end of induction or relapse from CR., CR is defined as meeting all of the following for at least 4 weeks (ie, no recurrence): 1. No circulating blasts and <5% blasts in the BM. 2. Normal maturation of all cellular components in the BM. 3. No extramedullary disease (CNS involvement, lymphadenopathy, splenomegaly, skin/gum infiltration, testicular mass). 4. ANC >1000/μl (or >1.0*10^9/L). 5. Platelets >100,000/μl (or >100*10^9/L)., CRi is defined as hematologic complete remission with incomplete hematologic recovery and meeting all criteria for CR except platelet count and/or ANC., ORR is defined as CR + CRi., Duration of MRD-negative CR is defined as the interval between the first assessment at which the criteria for MRD-negative CR are met until the earliest date at which loss of MRD negativity or relapse from CR occurs., Duration of CR is defined as the interval between the first assessment at which the criteria for CR are met until the earliest date at which relapse from CR occurs., Time to treatment failure is defined as time to end of study-randomized treatment (except for hematopoietic stem cell transplantation [HSCT] without loss of MRD-negative CR) due to safety and/or efficacy reasons., Molecule response is assessed by 3-Log Reduction (MR3), Molecular Response 4-Log Reduction (MR4) and Molecular Response 4.5-Log Reduction (MR4.5)., PIF is defined as participants who received treatment for chromosomepositive acute lymphoblastic leukemia (ALL) but never achieved CR or CRi by the end of induction. PIF is not limited by the number of unsuccessful treatments; this disease status only applies to recipients who have never been in CR or CRi., MR4.5 is molecular response 4.5-log reduction (≤0.0032% BCRABL1/ABL1), or undetectable BCR-ABL1 transcripts in cDNA with ≥ 32,000 ABL1 transcripts., On-study participants with or without HSCT will be evaluated. OS is defined as the interval between randomization and death due to any cause, censored at the last contact date when the participant was alive., On-study participants with or without HSCT will be evaluated. Relapse from CR is defined as reappearance of blasts in the blood or BM (>5%) or in any extramedullary site after a CR., OS is defined as interval between randomization and death due to any cause, censored at the last contact date when the participant was alive., Exploratory end point: Biomarkers of disease sensitivity and resistance to ponatinib and imatinib and/or biomarkers affecting ponatinib efficacy or safety.

Source: https://euclinicaltrials.eu/ctis-public/view/2023-508463-71-00